EU clinical trial 2024-515831-31-00: Evaluation of the efficacy of intra venous dornase alfa (Pulmozyme®) on arterial recanalization in post-thrombectomy angiography in patients managed for ischemic stroke with thrombolysis and eligible for thrombectomy: a single-center phase II trial.
Protocol code: JDS_2021_5
Sponsor: Fondation A De Rothschild (Hospital/Clinic/Other health care facility). Phase: Therapeutic exploratory (Phase II). Countries: France (ended).
Therapeutic area(s): Diseases [C] - Nervous System Diseases [C10]; Diseases [C] - Cardiovascular Diseases [C14]; Analytical,Diagnostic,Therapeutic Techniques and Equipment [E]-Surgical Procedures, Operative [E04]
Gender: Female, Male. Age: 18-64 years, 65+ years. Enrolment: 44.
Status: Ended. Start date (EU): 2022-08-19. End date (EU): 2025-10-29. Decision date: 2024-07-26. Results received: No. Last updated: 2024-10-22.

Condition(s): Ischemic stroke
Product: PULMOZYME 2500 U/2,5 ml, solution pour inhalation par nébuliseur

Primary endpoint: Complete recanalisation defined by a revised TICI score of 2C or 3 (Appendix 1) on post-MT cerebral angiography. - If the TM procedure is completed before 1 hour after the start of the dornase alfa infusion and the revised TICI score is <3, a second post-MT angiography, 1 hour after the start of the dornase alfa infusion, will be performed to assess the TICI score for the primary endpoint., Complete recanalisation defined by a revised TICI score of 2C or 3 (Appendix 1) on post-MT cerebral angiography. - If the TM procedure is completed before 1 hour after the start of the dornase alfa infusion and the revised TICI score is 3, the immediate post-TM angiography will be used to assess the TICI score for the primary endpoint., Complete recanalisation defined by a revised TICI score of 2C or 3 (Appendix 1) on post-MT cerebral angiography. - If the duration of the TM procedure is > 1 hour after the start of the dornase alfa infusion, the immediate post-TM angiogram will be used to assess the TICI score for the primary endpoint.
Endpoint(s): Early recanalisation defined by a revised TICI score of 2b, 2c or 3 on pre-thrombectomy cerebral angiography, Improvement of at least one grade in the revised TICI score between cerebral angiography after the last pass of TM and that performed 1 hour after the start of the dornase alfa infusion (for TM procedures <1 hour), Duration of thrombectomy procedure defined by the time (in minutes) between arterial puncture and recanalisation, Number of thrombectomy operations, Intra-procedural ENT defined by the appearance on cerebral angiography of arterial occlusion in an initially unaffected territory during or at the end of mechanical thrombectomy, Cerebral infarct volume measured on cerebral MRI between 24 and 36 hours after thrombolysis, Haemorrhagic transformation assessed on a brain scan at 24-36 hours using the ECASS 3 scale (Appendix 2), Decrease in NIHSS score (Appendix 3) > 8 points between the pre-thrombolysis score and the score 24-36 hours after thrombectomy, Favourable functional prognosis at 3 months defined by a modified Rankin score of less than 3 (Appendix 4), All-cause death 3 months after ischaemic stroke, Changes in concentrations of thrombolysis blood markers (D-dimers, plasmin-antiplasmin complex, DNAse, fibrinogen degradation products, free DNA) between : before Pulmozyme administration (sample taken when the patient arrived in the NRI unit) and after administration (sample taken at the end of thrombectomy), Adverse events and serious/non-serious adverse reactions

Source: https://euclinicaltrials.eu/ctis-public/view/2024-515831-31-00